EU clinical trial 2022-501217-31-00: PRODIGE 81-FFCD 2101-TRIPLET: Randomized, open-label, phase II-III study evaluating the benefit of adding Ipilimumab to the combination of Atezolizumab and Bevacizumab in patients with hepatocellular carcinoma receiving first-line systemic therapy
Protocol code: PRODIGE81-TRIPLET
Sponsor: Fondation Franc.Cancerologie Digestive (Hospital/Clinic/Other health care facility). Phase: Phase II and Phase III (Integrated). Countries: France (ongoing, recruitment ended).
Therapeutic area(s): Diseases [C] - Digestive System Diseases [C06]; Phenomena and Processes [G] - Immune system processes [G12]
Gender: Female, Male. Age: 18-64 years, 65+ years. Enrolment: 574.
Status: Ongoing, recruitment ended. Start date (EU): 2023-03-09. Decision date: 2022-10-27. Results received: No. Last updated: 2024-11-27.

Condition(s): Hepatocellular carcinoma
Product: ATEZOLIZUMAB, YERVOY 5 mg/ml concentrate for solution for infusion, Tecentriq 1,200 mg concentrate for solution for infusion, BEVACIZUMAB, BEVACIZUMAB

Primary endpoint: Phase II : objective response (complete response or partial response)within the first 24 weeks (9 cycles) for both arms treatment, Phase III : overall survival between the two arms
Endpoint(s): Radiation progression-free survival (PFS), Objective response rate (OR) under treatment, Rate of disease control (complete response or partial response or stability), Response time, Median time to progression, Median time to WHO degradation>2, Time to objective response, Tolerance (NCI CTC v4.0 assessed treatment and non-treatment related adverse events (bevacizumab and immunotherapy), Rate of permanent discontinuation of protocol treatment due to a study treatment-related effect., Quality of life according to the EORTC QLQ-C30 and its HCC supplement EORTC QLQ-HCC18, time to deterioration of the quality of life score., Overall survival (median) - Phase II patients

Source: https://euclinicaltrials.eu/ctis-public/view/2022-501217-31-00